EU clinical trial 2024-513889-19-00: MInimal residual Disease Adapted Strategy / IFM 2020-02: frontline therapy for patients eligible for autologous stem cell transplantation less than 66 years; a prospective study from the French cooperative group IFM
Protocol code: MIDAS:IFM 2020-02
Sponsor: Intergroupe Francophone Du Myelome (Patient organisation/association). Phase: Therapeutic confirmatory (Phase III). Countries: Belgium (authorised, recruitment pending), France (authorised, recruitment pending).
Therapeutic area(s): Diseases [C] - Neoplasms [C04]; Diseases [C] - Hemic and Lymphatic Diseases [C15]
Gender: Female, Male. Age: 18-64 years. Enrolment: 791.
Status: Authorised, recruitment pending. Decision date: 2024-11-19. Results received: No. Last updated: 2026-03-26.
Decision dates by country: FR: 2024-12-05, BE: 2024-11-19

Condition(s): Multiple Myeloma
Product: Kyprolis 60 mg powder for solution for infusion, Revlimid 5 mg hard capsules, Iberdomide, Revlimid 25 mg hard capsules, SARCLISA 20mg/mL concentrate for solution for infusion., Neofordex 40 mg tablets, DECTANCYL 0,5 mg, comprimé, Revlimid 10 mg hard capsules, Isatuximab, Iberdomide, SARCLISA 20mg/mL concentrate for solution for infusion.

Primary endpoint: For both parts of the trial (A vs B and C vs D), the primary comparison of the 2 strategies will be made with respect to negative MRD rate (10-6 NGS) before maintenance using the chi square test in the ITT population. The observed MRD negative rate will be provided along with its 2-sided 95% Confidence interval (CI). Treatment effect will be described by an Odds Ratio, along with its 2-sided 95% confidence interval, by fitting a logistic regression model adjusted on stratification variables
Endpoint(s): Sustained MRD rate at year 2, 3, 4 post inclusion will be analyzed similarly to the primary endpoint., For Overall Survival (OS), the distribution of OS since randomization will be estimated using Kaplan Meier method. The comparison of the 2 arms will be made by log-rank test., Treatment effect will be described by Hazard Ratio and its 2-sided 95% confidence intervals are will be estimated using a Cox regression model adjusted on stratification variables (with high risk cytogenetics and MRD negative rate (10-5 NGS) after induction as fixed effects and center as random effects for A vs B comparison, and high risk cytogenetics as fixed effects and center as random effects for C vs D comparison)., Progression Free survival, defined as time from randomization to either progression or death will be analyzed similarly

Source: https://euclinicaltrials.eu/ctis-public/view/2024-513889-19-00